EU clinical trial 2024-514527-42-00: An open, randomised, controlled phase II trial of CellProtect in combination with Isatuximab antibody versus Isatuximab antibody alone as maintenance treatment in patients with Multiple Myeloma undergoing high dose treatment (ISA-HC-NK)
Protocol code: ISA-HC-NK
Sponsor: Karolinska Institutet (Educational Institution). Phase: Therapeutic exploratory (Phase II). Countries: Sweden (ongoing, recruitment ended).
Therapeutic area(s): Diseases [C] - Neoplasms [C04]; Diseases [C] - Hemic and Lymphatic Diseases [C15]
Gender: Female, Male. Age: 18-64 years, 65+ years. Enrolment: 62.
Status: Ongoing, recruitment ended. Start date (EU): 2023-07-28. Decision date: 2024-09-26. Results received: No. Last updated: 2024-09-26.

Condition(s): Multiple myeloma
Product: SARCLISA 20mg/mL concentrate for solution for infusion., CellProtect

Primary endpoint: Enhancement of ORR (yes/no), defined as “yes” for patients that show an increase in ORR at Visit 15 (start of cycle 4) as compared to Visit 2 (baseline), and “no” otherwise.
Endpoint(s): Overall Response Rate (ORR, scores 1-7) defined as the highest class fulfilled by the patient at one time point: 1. PD, 2. SD or MR (SD, not fulfilling PD, MR, PR, VGPR or CR, or Minimal Response, ≥ 25% reduction in serum M-protein), 3.PR ≥ 50% reduction in serum M-protein, 4. VGPR ≥ 90% reduction in serum M-protein, 5. CR (Serum immunofixation not measurable), 6. Flow MRD negative, 7. Sustained MRD negative (compared to Visit 2), Treatment-emergent adverse events/serious adverse events (TEAEs/SAEs) (including IARs), Laboratory parameters, Vital signs, Weight, ECOG PS, Findings from physical examination

Source: https://euclinicaltrials.eu/ctis-public/view/2024-514527-42-00